EU clinical trial 2024-513069-37-00: Phase 1 Single Ascending Doses (SAD) of M5542 in Healthy Participants
Protocol code: MS201491_0001
Sponsor: Merck Healthcare KGaA (Pharmaceutical company). Phase: Human Pharmacology (Phase I)- First administration to humans. Countries: Germany (ongoing, recruiting).
Therapeutic area(s): Not possible to specify
Gender: Female, Male. Age: 18-64 years. Enrolment: 49.
Status: Ongoing, recruiting. Start date (EU): 2026-01-30. Decision date: 2024-08-09. Results received: No. Last updated: 2026-01-16.

Condition(s): Healthy

Source: https://euclinicaltrials.eu/ctis-public/view/2024-513069-37-00